EU clinical trial 2023-509357-31-00: A Study to Investigate the Safety, Tolerability, Immunogenicity, Pharmacokinetics, and Pharmacodynamics of RO7121932 following Intravenous and Subcutaneous Administration in Participants with Multiple Sclerosis
Protocol code: BP42230
Sponsor: F. Hoffmann-La Roche AG (Pharmaceutical company). Phase: Human Pharmacology (Phase I)- First administration to humans. Countries: Germany (ongoing, recruiting), Poland (ongoing, recruiting), Romania (ongoing, recruiting), Portugal (ongoing, recruiting), Italy (ongoing, recruiting), Belgium (ongoing, recruiting), Spain (ongoing, recruiting).
Therapeutic area(s): Diseases [C] - Nervous System Diseases [C10]
Gender: Female, Male. Age: 18-64 years, 65+ years. Enrolment: 55.
Status: Ongoing, recruiting. Start date (EU): 2021-06-01. Decision date: 2024-03-15. Results received: No. Last updated: 2026-07-15.
Decision dates by country: IT: 2024-03-18, BE: 2024-03-28, PT: 2024-03-15, PL: 2024-04-10, DE: 2024-03-19, RO: 2024-03-19, ES: 2025-02-24

Condition(s): Multiple Sclerosis (MS)

Source: https://euclinicaltrials.eu/ctis-public/view/2023-509357-31-00